EU clinical trial 2024-518765-96-00: Role of [68Ga]Ga-FAPI PET/CT in oncological patients with doubtful or inconclusive findings at [18F]F-FDG PET/CT
Protocol code: FAPI-MN-2020
Sponsor: Azienda Ospedaliero-Universitaria Di Bologna IRCCS Istituto Di Ricerca E Di Cura A Carattere Scientifico (Hospital/Clinic/Other health care facility). Phase: Therapeutic exploratory (Phase II). Countries: Italy (ongoing, recruiting).
Therapeutic area(s): Diseases [C] - Neoplasms [C04]
Gender: Female, Male. Age: 18-64 years, 65+ years. Enrolment: 200.
Status: Ongoing, recruiting. Start date (EU): 2021-06-03. Decision date: 2024-11-27. Results received: No. Last updated: 2025-05-12.

Condition(s): oncological disease suspicion/ new diagnosis or with a previously treated tumour, with an inconclusive or equivocal findings after the standard clinical/diagnostic flow chart: [18F]F-FDG PET/CT
Product: 68Ga-FAPI-46

Primary endpoint: Accuracy of PET / CT with 68Ga-FAPI in detecting the presence of disease in patients for whom, upon completion of the clinical and instrumental diagnostic procedures required by their normal care pathway, the diagnostic doubt remains: PET / CT examination with 18F-FDG result doubt for the presence of oncological disease or inconclusive in satisfying this diagnostic question.The accuracy of PET / CT with 68Ga-FAPI will be calculated with the following statistical formula: (TRUE POSITIVE+TRUE NE
Endpoint(s): Evaluation of the accuracy, sensitivity and specificity of PET / CT with 68Ga-FAPI and PET / CT with 18F-FDG in detecting the presence of disease in patients for whom, upon completion of the clinical and instrumental diagnostic procedures required by their normal course care, the diagnostic doubt remains: PET / CT examination with 18F-FDG resulted in doubt due to the presence of oncological disease or inconclusive in satisfying this diagnostic question.

Source: https://euclinicaltrials.eu/ctis-public/view/2024-518765-96-00